EU clinical trial 2024-512635-71-00: A PHASE II, OPEN LABEL, RANDOMIZED, NON-COMPARATIVE COHORTS STUDY OF ADJUVANT ATEZOLIZUMAB OR ATEZOLIZUMAB PLUS TIRAGOLUMAB IN SOLID TUMORS WITH RESECTABLE DISEASE WITH INTERMEDIATE-HIGH RISK OF RECURRENCE AND HIGH TUMOR MUTATIONAL BURDEN (TMB-H) OR MICROSATELLITE INSTABILITY (MSI-H) (IMperator)
Protocol code: ML43332
Sponsor: Roche Farma S.A. (Pharmaceutical company). Phase: Therapeutic exploratory (Phase II). Countries: Spain (ended).
Therapeutic area(s): Diseases [C] - Neoplasms [C04]
Gender: Female, Male. Age: 18-64 years, 65+ years. Enrolment: 40.
Status: Ended. Start date (EU): 2024-03-14. End date (EU): 2024-12-09. Decision date: 2024-05-17. Results received: No. Last updated: 2024-10-28.

Condition(s): Solid tumors
Product: Tecentriq 840 mg concentrate for solution for infusion, Tiragolumab

Primary endpoint: The primary endpoint is the Disease Free Survival (DFS) rate at 24 months defined as the proportion of patients who have not suffered any of the following since the time of randomization: first documented recurrence of disease, new primary tumor or death due to any cause, whichever occurs first
Endpoint(s): DFS rate at 36, 48 and 60 months, OS (Overall Survival) after randomization, defined as the time from randomization to death from any cause, Incidence and severity of AEs, with severity determined according to the National Cancer Institute (NCI) Common Terminology Criteria for Adverse Events, Version 5.0 (CTCAE v5.0), Change from baseline in targeted clinical laboratory test results, Tumor biomarker: Percentage of PDL1 positive cells versus DFS and OS, Genomics: Genomic alterations related to resistance to immunotherapy versus DFS and OS

Source: https://euclinicaltrials.eu/ctis-public/view/2024-512635-71-00